EU clinical trial 2024-516380-81-00: A Multicenter, Rollover Study to Evaluate the Long-Term Safety and Efficacy of Atacicept
Protocol code: VT-001-0051
Sponsor: Vera Therapeutics Inc. (Pharmaceutical company). Phase: Therapeutic exploratory (Phase II). Countries: Belgium (ongoing, recruiting), Germany (ongoing, recruiting), Greece (ongoing, recruiting), Czechia (ongoing, recruiting), Poland (ongoing, recruiting), Spain (authorised, recruiting).
Therapeutic area(s): Diseases [C] - Pathological Conditions, Signs and Symptoms [C23]
Gender: Female, Male. Age: 18-64 years, 65+ years. Enrolment: 30.
Start date (EU): 2025-02-28. Decision date: 2025-01-31. Results received: No. Last updated: 2026-05-22.
Decision dates by country: DE: 2025-01-31, CZ: 2025-04-10, PL: 2025-02-17, BE: 2025-01-31, GR: 2025-02-04, ES: 2026-05-22

Condition(s): Treatment of IgAN
Product: Atacicept Autoinjector Combination, Atacicept

Primary endpoint: Long-term safety and tolerability of atacicept as assessed by routine clinical and laboratory tests and adverse events
Endpoint(s): The effect of atacicept on the following: *Changes in proteinuria based on UPCR and UACR as determined by spot urine. *Changes in estimated glomerular filtration rate (eGFR) based on serum creatinine and cystatin C, respectively. *Hematuria level based on blood on urine dipstick. *Changes in serum Gd-IgA1 levels.

Source: https://euclinicaltrials.eu/ctis-public/view/2024-516380-81-00